EU clinical trial 2025-523306-33-00: Obinutuzumab Treatment in Frequently Relapsing and Rituximab-Dependent Idiopathic Nephrotic Syndrome in Adults: a fully academic, single-arm, open, prospective, intervention trial
Sponsor: Istituto Di Ricerche Farmacologiche Mario Negri (Laboratory/Research/Testing facility). Phase: Therapeutic exploratory (Phase II). Countries: Italy (ongoing, recruiting).
Therapeutic area(s): Diseases [C] - Immune System Diseases [C20]
Gender: Female, Male. Age: 18-64 years, 65+ years. Enrolment: 10.
Status: Ongoing, recruiting. Start date (EU): 2026-03-12. Decision date: 2026-02-23. Results received: No. Last updated: 2026-05-26.

Condition(s): Idiopathic Nephrotic Syndrome
Product: OMNIPAQUE 300 mg I/ml soluzione iniettabile, Gazyvaro 1,000 mg concentrate for solution for infusion.

Primary endpoint: Number of participants who are relapse-free for 12 months after Obinutuzumab treatment
Endpoint(s): Time to protein increase to >3.5g/24H or P/C>3500 mg/g along with serum albumin <3.5 g/dl, Time to B-cell increase to > 5cells/mm3, Changes in Serum creatinine level, urea, eGFR (by CKD-Epi equation) and mGFR (measured at 6, 12, 18 and 24 months by the iohexol plasma clearance techniques)., Changes in hematologic parameters (serum total protein, albumin, total, LDL and HDl cholesterol, triglycerides) and in urine parameters (24-hour proteinuria and albuminuria) along with edema and body weight, Changes in total protein, albumin and IgG fractional clearances, Changes in participant health-related quality of life as measured by means of the SF-12 questionnaire

Source: https://euclinicaltrials.eu/ctis-public/view/2025-523306-33-00